EU clinical trial 2025-522190-11-01: AIEOP-BFM ALL 2025 - International collaborative treatment protocol for children and adolescents with acute lymphoblastic leukemia
Protocol code: AIEOP-BFM ALL 2025
Sponsor: Universitaetsklinikum Schleswig-Holstein AöR (Hospital/Clinic/Other health care facility). Phase: Therapeutic confirmatory (Phase III). Countries: Germany (authorised, recruitment pending).
Therapeutic area(s): Diseases [C] - Neoplasms [C04]; Diseases [C] - Hemic and Lymphatic Diseases [C15]
Gender: Female, Male. Age: 0-17 years. Enrolment: 2250.
Status: Authorised, recruitment pending. Decision date: 2026-07-09. Results received: No. Last updated: 2026-07-09.

Condition(s): acute lymphoblastic leukemia in children and adolescents
Product: METHOTREXATE, CYCLOPHOSPHAMIDE, MERCAPTOPURINE, VINCRISTINE, PEGASPARGASE, BLINCYTO 38.5 micrograms powder for concentrate and solution for solution for infusion., CYTARABINE, DEXAMETHASONE, TIOGUANINE, Enrylaze 10 mg/0.5 mL solution for injection/infusion., DOXORUBICIN

Primary endpoint: B/SR: Disease-free survival time: Time from randomization (R-SR) until the date of last follow-up or the first event defined as relapse, second malignancy or death from any cause
Endpoint(s): B/SR: Survival: Time from randomization until the date of last follow-up or to death from any cause., B/SR: Cumulative incidence of treatment-related mortality (in CCR), B/SR: Cumulative incidence of relapse, B/SR: Frequency of Adverse Events of interest and Serious Adverse Events in randomized protocol phases, B/SR: Number of days of inpatient treatment, B/SR: Quality of life (separate add on study)

Source: https://euclinicaltrials.eu/ctis-public/view/2025-522190-11-01